EU clinical trial 2024-512319-40-00: Comparative PK, PD, efficacy, safety and immunogenicity assessment of the proposed ocrelizumab biosimilar CYB704 and Ocrevus in participants with relapsing multiple sclerosis (STRIVE-MS)
Protocol code: CCYB704A12301
Sponsor: H e x a l AG (Pharmaceutical company). Phase: Therapeutic confirmatory (Phase III). Countries: Croatia (ongoing, recruitment ended), Bulgaria (ongoing, recruitment ended), Poland (ongoing, recruitment ended).
Therapeutic area(s): Diseases [C] - Nervous System Diseases [C10]
Gender: Female, Male. Age: 18-64 years. Enrolment: 126.
Status: Ongoing, recruitment ended. Start date (EU): 2025-07-01. Decision date: 2025-06-01. Results received: No. Last updated: 2026-06-08.
Decision dates by country: HR: 2025-06-02, BG: 2025-06-02, PL: 2025-06-01

Condition(s): Subjects with relapsing multiple sclerosis (relapsing remitting MS or active secondary progressive MS)

Source: https://euclinicaltrials.eu/ctis-public/view/2024-512319-40-00